EU clinical trial 2024-519479-24-00: Upfront trastuzumab-deruxtecan plus capecitabine and bevacizumab for patients with HER2 positive metastatic colorectal cancer: the CHIMERA trial
Sponsor: Fondazione GONO G.I. (Patient organisation/association). Phase: Therapeutic exploratory (Phase II). Countries: Germany (authorised, recruitment pending), France (ongoing, recruiting), Italy (ongoing, recruiting), Spain (ongoing, recruiting).
Therapeutic area(s): Diseases [C] - Neoplasms [C04]
Gender: Female, Male. Age: 18-64 years, 65+ years. Enrolment: 42.
Start date (EU): 2025-11-21. Decision date: 2025-10-02. Results received: No. Last updated: 2026-06-03.
Decision dates by country: FR: 2025-10-02, DE: 2025-10-07, IT: 2025-10-06, ES: 2025-10-06

Condition(s): metastatic colorectal cancer
Product: CAPECITABINE, BEVACIZUMAB, Enhertu 100 mg powder for concentrate for solution for infusion

Primary endpoint: to evaluate the activity of upfront T-DXd, capecitabine and bevacizumab in terms of confirmed ORR by BICR. Overall response rate will be defined as the proportion of patients who achieve either a partial or complete response as best responses to study treatment.
Endpoint(s): Progression-free survival (PFS) by BICR and Investigator assessment, defined as the time from treatment start to radiological evidence of disease progression (as per RECIST v1.1 criteria) or death, whichever occurs first., Overall survival (OS), defined as the time from treatment start to death., Treatment safety, defined as the incidence of adverse events during treatment and follow-up, assessed according to CTCAE v5.0., Disease control rate (DCR) by BICR and Investigator assessment, defined as the proportion of subjects achieving a complete response (CR), partial response (PR) or stable disease (SD) as best response during study treatment, as per RECIST v1.1., Early tumor shrinkage (ETS), defined as the proportion of patients achieving a reduction in tumor size of at least 20% at first radiological reassessment., Duration of response (DOR), defined as the time from first radiological evidence of complete or partial response to disease progression or death whichever occurs first, Depth of response (DoR) defined as the maximum percentage of tumor shrinkage at best response relative to baseline., Patients reported outcomes (completion of quality-of-life questionnaires), CEA and CA19.9 dynamics and their correlation with activity and efficacy outcomes., Central review of HER2 status (VENTANA anti-HER2/neu 4B5 Rabbit Monoclonal Primary Antibody and VENTANA HER2 Dual ISH Probe Cocktail)

Source: https://euclinicaltrials.eu/ctis-public/view/2024-519479-24-00